EU clinical trial 2023-508041-40-00: A Study to Investigate Relative Bioavailability of Two Different Dosage Forms for Tozorakimab via Subcutaneous Administration in Healthy Volunteers
Protocol code: D9180C00011
Sponsor: AstraZeneca AB (Pharmaceutical company). Phase: Human Pharmacology (Phase I)- Other. Countries: Germany (ended).
Therapeutic area(s): Diseases [C] - Respiratory Tract Diseases [C08]
Gender: Female, Male. Age: 18-64 years. Enrolment: 46.
Status: Ended. Start date (EU): 2024-03-19. End date (EU): 2024-09-09. Decision date: 2024-03-13. Results received: No. Last updated: 2024-09-06.

Condition(s): healthy volunteers

Source: https://euclinicaltrials.eu/ctis-public/view/2023-508041-40-00